EU clinical trial 2024-512651-20-00: A Phase 2, Multicenter, Open-label Study to Evaluate the Pharmacokinetics and Safety of RLYB212 in Pregnant Women at Higher Risk for HPA-1a Alloimmunization
Protocol code: IPA2202
Sponsor: Rallybio Ipa LLC (Pharmaceutical company). Phase: Therapeutic exploratory (Phase II). Countries: Netherlands (ended), Norway (ended), Belgium (ended), Sweden (ended).
Therapeutic area(s): Diseases [C] - Congenital, Hereditary, and Neonatal Diseases and Abnormalities [C16]
Gender: Female. Age: 18-64 years. Enrolment: 8.
Status: Ended. Start date (EU): 2024-11-20. End date (EU): 2025-10-01. Decision date: 2024-10-01. Results received: Yes. Last updated: 2025-05-26.
Decision dates by country: SE: 2024-10-03, BE: 2024-10-01, NL: 2024-10-01, NO: 2024-10-02

Condition(s): Fetal and Neonatal Alloimmune Thrombocytopenia due to Human Platelet Antigen 1 incompatibility

Primary endpoint: Maternal PK parameters: ○ half-life of RLYB212 (t½); ○ max RLYB212 concentration (Cmax); ○ time to maximum RLYB212 concentration (tmax); ○ apparent clearance (CL/F) of RLYB212; ○ apparent volume of distribution (Vd); ○ area under the RLYB212 concentration versus time curve (AUC), • Type, seriousness, and incidence of AEs; • Physical examination findings; • Vital signs; • Maternal clinical laboratory values; • ECG; • Obstetric/fetal doppler ultrasound
Endpoint(s): Concentration of RLYB212 in cord blood, • Type, seriousness, and incidence of AEs including fetal/neonatal AEs; • Physical examination findings, including APGAR score; • Vital signs, Development of ADAs (anti-drug antibody), Number of: Spontaneous abortions: non-deliberate fetal death before gestational wk (GW) 20; Elective abortions: deliberate termination of pregnancy at any stage; Stillbirths: non-deliberate fetal death on or after GW 19 wks; Premature births: live birth prior to 37 completed GW; Live births (37 or more completed GW); Health/development of infants up to 4-6 wks of age, Neonatal thrombocytopenia and severe neonatal thrombocytopenia, as defined by a platelet count < 150 × 10^9/L and < 50 × 10^9/L respectively, within 72 hours of parturition, Presence of maternal anti-HPA-1a alloantibodies at Week 10 post pregnancy

Source: https://euclinicaltrials.eu/ctis-public/view/2024-512651-20-00